EU clinical trial 2024-514127-42-00: A Phase 2, Open-Label Study to Evaluate the Pharmacokinetics, Safety, Tolerability, and Pharmacodynamics of Crinecerfont in Pediatric Subjects 0 to <2 Years of Age With Congenital Adrenal Hyperplasia
Protocol code: NBI-74788-CAH2011
Sponsor: Neurocrine Switzerland GmbH (Pharmaceutical company). Phase: Therapeutic exploratory (Phase II). Countries: Germany (ongoing, recruiting).
Therapeutic area(s): Diseases [C] - Hormonal diseases [C19]
Gender: Female, Male. Age: 0-17 years. Enrolment: 10.
Status: Ongoing, recruiting. Start date (EU): 2025-10-16. Decision date: 2025-07-01. Results received: No. Last updated: 2026-07-03.

Condition(s): Congenital adrenal hyperplasia (CAH)
Product: NBI-74788

Primary endpoint: Plasma concentrations of crinecerfont at Days 7 and 15
Endpoint(s): Incidence of treatment-emergent adverse events (TEAEs)

Source: https://euclinicaltrials.eu/ctis-public/view/2024-514127-42-00